EU clinical trial 2022-502770-16-00: Treatment of Gastroesophageal Reflux Disease in Infants- a Randomized Controlled Trial
Protocol code: 2022-502770-16-00
Sponsor: Odense University Hospital (Hospital/Clinic/Other health care facility). Phase: Phase III and phase IV (Integrated). Countries: Denmark (ongoing, recruiting).
Therapeutic area(s): Diseases [C] - Digestive System Diseases [C06]
Gender: Female, Male. Age: 0-17 years. Enrolment: 96.
Status: Ongoing, recruiting. Start date (EU): 2025-10-27. Decision date: 2024-11-04. Results received: No. Last updated: 2026-03-27.

Condition(s): GERD, Cows' milk allergy
Product: OMEPRAZOLE, Omeprazole Placebo, 2 mg/ml, Powder For Oral Suspension

Primary endpoint: Parent-reported reduction in the weekly number of reflux-episodes (compared to run-in) after four weeks treatment, in the active groups, compared to the control group (placebo). The outcome is registered daily in an App.
Endpoint(s): Reduction of number of reflux episodes (compared to run-in) in the PPI group, compared to the diet group., Change from baseline in weight after 4 weeks. A nurse or physician will perform the measurement on a weight in the clinic/hospital. Measurement unit: gram., Change from baseline in the number of reflux episodes with visible blood. Parent reported weekly number of reflux episodes with visible blood. Registered in MyCap App. [Time Frame: 1,2,3,4 weeks], Change from baseline in the numbers of episodes with crying Parent reported weekly numbers of episodes with crying 5 minutes after feeding. Registered in MyCap App.[Time Frame: 1,2,3,4 weeks], Change from baseline in the number of episodes of refusing breast/ bottle Parent reported weekly numbers of episodes of refusing breast/bottle. Registered in MyCap App. [Time Frame: 1,2,3,4 weeks], Change from baseline in the number of episodes with short breathing pauses. Parent-reported weekly numbers of episodes with short breathing pauses. Registered in MyCap App. [Time Frame: 1,2,3,4 weeks], Change from baseline in the number of episodes with paleness/blue color in face or lips. Parent reported weekly numbers of episodes with paleness/blue color in face. Registered in MyCap App. [Time Frame: 1,2,3,4 weeks], Change from baseline in the number of episodes with troublesome breathing/cough. Parent reported weekly numbers of episodes with troublesome breathing/cough. Registered in MyCap App. [Time Frame: 1,2,3,4 weeks], Change from baseline in the number of episodes with discomfort. Parent reported weekly episodes with discomfort 5 min after feeding. Registered in MyCap App. [Time Frame: 1,2,3,4 weeks], Immunoglobulin E level. Blood positive/negative for specific immunoglobulin E for cows milk protein. Values above 0,35 kU/l are considered positive for cows’ milk allergy. [Time Frame: 4 weeks after treatment is started], Adverse events to trial medicine in the proton pump inhibitor group and the control (placebo) group. Any parent-reported adverse events to the trial medicine (both Omeprazole and placebo) are registered weekly. There are several well-known side effects; 1-10 % experience symptoms from the gastrointestinal tract (i.e., stomach pain, nausea, and constipation), skin, airways, and increased susceptibility to infections. [Time Frame: 1,2,3,4 weeks], Confirmation of cows' milk allergy. After 4 weeks´ of cows milk protein-free diet, an oral provocation test with cow’s milk is conducted on all infants in the diet group, who experienced effect of the diet. The test will be carried out in the hospital. A nurse records any symptoms experienced during the first few hours of the test, and the parents are required to monitor and report any late symptoms via phone call 48 hours after the test., Change from baseline in the size of reflux episodes. Registered in MyCap App daily.

Source: https://euclinicaltrials.eu/ctis-public/view/2022-502770-16-00